EU clinical trial 2025-521569-29-00: A non-commercial, randomized, open-label clinical trial to evaluate the efficacy of 1.8-cineole compared to mupirocin in the treatment of chronic rhinitis caused by carriage of methicillin-resistant Staphylococcus aureus (NOSE)
Protocol code: 2024/ABM/01/00042
Sponsor: Wroclaw Medical University (Educational Institution). Phase: Therapeutic confirmatory (Phase III). Countries: Poland (not authorised).
Therapeutic area(s): Diseases [C] - Otorhinolaryngologic Diseases [C09]
Gender: Female, Male. Age: 18-64 years, 65+ years. Enrolment: 300.
Status: Not authorised. Decision date: 2026-04-07. Results received: No. Last updated: 2026-04-07.

Condition(s): chronic active Staphylococcus aureus mono-infection/asymptomatic carriage in the nasal cavity
Product: CINEOLE, MUPIROCIN

Primary endpoint: the efficacy of 18C in monotherapy and combination therapy in patients with chronic active monoinfection/carriage of Staphylococcus aureus in the nasal cavity, as determined by microbiological analysis (both qualitative and quantitative) immediately after 7 days of therapy.
Endpoint(s): decrease in the prevalence of MRSA Staphylococcus aureus carriage (based on the results of the culture), decrease in the number of bacteria in nasal swabs (based on the results of the quantitative test), clinical improvement (according to the Lund-Kennedy endoscopic assessment scale, VAS pain severity score), ability of applied antimicrobials to eradicate MRSA biofilm in the controlled in vitro study, improvement in quality of life (assessed by the SNOT-22 - Sino-nasal Outcome Test questionnaire), evaluation of the durability of the therapeutic effect (based on the results of smears of microbiological examination 7, 14, 28 and 35 days after the end of treatment), the level of 1,8- cineole concentration in the tested samples (in exhaled air, mucous secretions, saliva measured by High- Speed GS-MS method)

Source: https://euclinicaltrials.eu/ctis-public/view/2025-521569-29-00